EU clinical trial 2023-508439-30-00: Safety Study to Compare the Gastrointestinal Tolerability of Oral Tegomil Fumarate and Dimethyl Fumarate (Tecfidera®) in Healthy Volunteers.
Protocol code: NXPTEGO/23/P1-4
Sponsor: Neuraxpharm Pharmaceuticals S.L. (Pharmaceutical company). Phase: Human Pharmacology (Phase I)- Other. Countries: Portugal (ended).
Therapeutic area(s): Diseases [C] - Nervous System Diseases [C10]
Gender: Female, Male. Age: 18-64 years. Enrolment: 210.
Status: Ended. Start date (EU): 2024-08-21. End date (EU): 2024-12-23. Decision date: 2024-03-15. Results received: No. Last updated: 2025-03-07.

Condition(s): Multiple Sclerosis

Source: https://euclinicaltrials.eu/ctis-public/view/2023-508439-30-00